EU clinical trial 2023-507842-10-00: Brain effects of hormonal contraceptives. A randomized, double-blind, longitudinal study comparing two combined oral contraceptives (Estetrol/drospirenone vs ethinylestradiol/levonorgestrel).
Sponsor: Region Uppsala (Hospital/Clinic/Other health care facility). Phase: Therapeutic use (Phase IV). Countries: Sweden (ended).
Therapeutic area(s): Diseases [C] - Female Urogenital Diseases and Pregnancy Complications [C13]
Gender: Female. Age: 18-64 years. Enrolment: 60.
Status: Ended. Start date (EU): 2024-03-18. End date (EU): 2025-06-08. Decision date: 2024-01-18. Results received: No. Last updated: 2024-04-12.

Condition(s): Contraception
Product: DROSPIRENONE AND ESTETROL, LEVONORGESTREL AND ETHINYLESTRADIOL

Primary endpoint: Change from baseline to treatment in grey matter volume grey matter surface and gyrification, white matter integrity and connectivity (DTI), resting state activity and reactivity during emotion processing
Endpoint(s): Change in DRSP score between baseline and treatment, Change in Quality of Life between baseline and treatment, Change in depressive symptoms and anxiety symptoms from baseline

Source: https://euclinicaltrials.eu/ctis-public/view/2023-507842-10-00